EU clinical trial 2025-523845-90-00: Safety and Preliminary Efficacy of CTX112 in Adult Participants with Relapsed/Refractory Hematologic Autoimmune Disease
Protocol code: CRSP-AID-501
Sponsor: CRISPR Therapeutics AG (Pharmaceutical company). Phase: Human Pharmacology (Phase I)- Other. Countries: Spain (authorised, recruiting), Germany (ongoing, recruiting), France (authorised, recruitment pending).
Therapeutic area(s): Diseases [C] - Hemic and Lymphatic Diseases [C15]
Gender: Female, Male. Age: 18-64 years, 65+ years. Enrolment: 55.
Start date (EU): 2026-06-09. Decision date: 2026-03-12. Results received: No. Last updated: 2026-08-05.
Decision dates by country: ES: 2026-04-21, FR: 2026-08-05, DE: 2026-04-29

Condition(s): Relapsed/Refractory Hematologic Autoimmune Disease

Source: https://euclinicaltrials.eu/ctis-public/view/2025-523845-90-00